EU clinical trial 2023-504520-26-00: Open label, long-term safety, tolerability, and efficacy study of GIVINOSTAT in all DMD patients who have been previously treated in one of the GIVINOSTAT studies.
Protocol code: DSC/14/2357/51
Sponsor: Italfarmaco S.p.A. (Pharmaceutical company). Phase: Therapeutic confirmatory (Phase III). Countries: Germany (ongoing, recruiting), Netherlands (ongoing, recruiting), Spain (ongoing, recruiting), France (ongoing, recruiting), Belgium (ongoing, recruiting), Italy (ongoing, recruiting).
Therapeutic area(s): Diseases [C] - Musculoskeletal Diseases [C05]
Gender: Male. Age: 0-17 years, 18-64 years. Enrolment: 120.
Status: Ongoing, recruiting. Start date (EU): 2017-10-19. Decision date: 2024-09-09. Results received: No. Last updated: 2025-07-11.
Decision dates by country: NL: 2024-09-10, BE: 2024-09-09, ES: 2024-09-09, DE: 2024-09-09, FR: 2024-09-17, IT: 2024-10-09

Condition(s): Duchenne Muscular Dystrophy (DMD)
Product: ITF2357

Primary endpoint: Type, incidence, and severity of treatment related/not related AEs and SAEs
Endpoint(s): For ambulant patients: Change from baseline in physical function as measured by 6MWT, NSAA, Time function tests (e.g. time to rise from floor, time to climb 4-stairs, time to 10m walk) (week 48 and then yearly till the end of the study), For ambulant patients: Change from baseline in muscle strength (e.g. knee extension and elbow flexion) as measured by HHM (week 48 and then yearly till the end of the study), For non-ambulant patients: Change in physical function from baseline in the Egen Klassifikation (EK) score (week 48 and then yearly till the end of the study), For non-ambulant patients: Change in patient and/or parent/caregiver reports of activities of daily living as measured by Barthel Index (week 48 and then yearly till the end of the study), For non-ambulant patients: Change in upper limbs muscle strength (week 48 and then yearly till the end of the study) evaluated by handheld myometry (HHM), For all patients: Change from baseline in physical function as measured by the Performance of Upper Limb (PUL) and MFM (week 48 and then yearly till the end of the study), For all patients: Change from baseline in respiratory function (week 48 and then yearly till the end of the study) (e.g. FVC, FEV1, PEF), For all patients: Change in patient and/or parent/caregiver reports of quality of life as measured by PedsQL for paediatric patients and by SF-36 for adults patients (week 48 and then yearly till the end of the study), For all patients: Age to major disease milestones (e.g. age at loss of ambulation, age at respiratory support needed during the day, age at scoliosis surgery, age at death)

Source: https://euclinicaltrials.eu/ctis-public/view/2023-504520-26-00